EU clinical trial 2024-510717-15-00: ABT-199 (Venetoclax) and Purine analogues as Novel Oral Drug Combination for Treatment of Relapsed/Refractory Acute Myeloid Leukemia (ApoAML)
Protocol code: 2282
Sponsor: Antwerp University Hospital (Hospital/Clinic/Other health care facility). Phase: Phase I and Phase II (Integrated)- Other. Countries: Belgium (authorised, recruitment pending).
Therapeutic area(s): Diseases [C] - Neoplasms [C04]
Gender: Female, Male. Age: 18-64 years, 65+ years. Enrolment: 30.
Status: Authorised, recruitment pending. Decision date: 2024-02-13. Results received: No. Last updated: 2024-02-13.

Condition(s): Acute myeloid leukemia
Product: MERCAPTOPURINE, VENETOCLAX

Primary endpoint: clinical response: - CR = complete remission (when all of the following: < 5% blasts in the bone marrow, no Auer rods, no extramedullary disease, neutrophils >1000/μl and transfusion independent). - CRi = morphologic complete remission with incomplete blood count recovery - CRp = CR with incomplete platelet recovery - MLFS = morphologic leukemia free state not meeting criteria for CR, CRi or CRp - PR = Partial remission (decrease of 50% of the blas
Endpoint(s): To assess the safety of treatment with a combination of venetoclax and 6-mercaptopurine in patients with AML

Source: https://euclinicaltrials.eu/ctis-public/view/2024-510717-15-00